EU clinical trial 2023-503628-22-00: A Phase III, Randomized, Double-Blind, Placebo-Controlled, Multicenter Study to Evaluate the Efficacy and Safety of Obinutuzumab in Patients with ISN/RPS 2003 Class III or IV Lupus Nephritis
Protocol code: CA41705
Sponsor: F. Hoffmann-La Roche AG (Pharmaceutical company). Phase: Therapeutic confirmatory (Phase III). Countries: Spain (ongoing, recruitment ended), Italy (ongoing, recruitment ended), Germany (ongoing, recruitment ended), France (ongoing, recruitment ended), Poland (ongoing, recruitment ended).
Therapeutic area(s): Diseases [C] - Immune System Diseases [C20]
Gender: Female, Male. Age: 18-64 years, 65+ years. Enrolment: 52.
Status: Ongoing, recruitment ended. Start date (EU): 2020-07-16. Decision date: 2024-01-12. Results received: No. Last updated: 2026-05-13.
Decision dates by country: FR: 2024-01-15, PL: 2024-02-23, DE: 2024-01-16, ES: 2024-01-12, IT: 2024-01-12

Condition(s): Lupus Nephritis (LN)
Product: METHYLPREDNISOLONE, PREDNISONE, Gazyvaro 1,000 mg concentrate for solution for infusion., Obinutuzumab placebo, Myfenax 500 mg film-coated tablets, DIPHENHYDRAMINE, PARACETAMOL

Primary endpoint: 1. Proportion of patients who achieve a CRR at Week 76
Endpoint(s): 1. Proportion of patients who achieve a proteinuric response at Week 76, 2. Proportion of patients who achieve CRR with successful prednisone taper at Week 76, 3. Proportion of patients who achieve an ORR evaluated at Week 50, 4. Proportion of patients who experience death or renal-related events through Week 76, 5. Mean change in eGFR from baseline to Week 76, 6. Change in anti-dsDNA titer from baseline to Week 50, 7. Change in C3 from baseline to Week 50, 8. Change in SLEDAI-2K from baseline to Week 76, 9. Time to onset of CRR over the course of 76 weeks, 10. Change in FACIT-F scale from baseline to Week 76, 11. Proportion of patients who achieve CRR with serum creatinine criteria at Week 76, 12. Incidence and severity of adverse events, with severity determined according to National Cancer Institute Common Terminology Criteria for Adverse Events version 5.0 (NCI CTCAE v5.0), 13. To characterize adverse events of special interest, including, among others, infusion-related reactions (IRRs), neutropenia, infections, and thrombocytopenia, 14. Change from baseline in targeted vital signs, 15. Change from baseline in targeted clinical laboratory test results, 16. Maximum observed concentration (Cmax) of obinutuzumab, 17. Minimum observed concentration (Cmin) of obinutuzumab, 18. Area under concentration-time curve (AUC) of obinutuzumab, 19. Clearance (CL) of obinutuzumab, 20. Prevalence of anti-drug antibodies (ADAs) at baseline and incidence of ADAs post-treatment during the study, 21. Total peripheral B-cell count at specified timepoints, 22. Time to lupus nephritis (LN) flare, 23. Time to unfavorable kidney outcome, 24. Mean change in eGFR from baseline, eGFR slope and proportion of participants achieving CRR over time

Source: https://euclinicaltrials.eu/ctis-public/view/2023-503628-22-00